EU clinical trial 2025-520869-52-00: The effects of vitamin D on bone, muscle and adipose tissue: a randomized double-blind phase IV study
Protocol code: DON3
Sponsor: Fondazione Policlinico Universitario Campus Bio-medico In Forma A Bbreviata Fon (Hospital/Clinic/Other health care facility). Phase: Therapeutic use (Phase IV). Countries: Italy (ongoing, recruiting).
Therapeutic area(s): Analytical, Diagnostic and Therapeutic Techniques and Equipment [E] - Therapeutics [E02]
Gender: Female, Male. Age: 65+ years. Enrolment: 80.
Status: Ongoing, recruiting. Start date (EU): 2025-01-31. Decision date: 2025-01-31. Results received: No. Last updated: 2026-03-27.

Condition(s): obese elderly people with vitamin D deficiency
Product: COLECALCIFEROL, The Placebo product consists only of pure Ph. Eur. refined olive and it differs from Test product for the absence of active substance only: therefore, there are no reasons to suspect that the placebo product will undergo changes in its physical characteristics or degradation., Placebo

Primary endpoint: Serum: Changes in the pro-inflammatory cytokine TNF-alpha will be evaluated via ELISA assay.
Endpoint(s): Muscle tissue: Nuclear magnetic resonance imaging of the ilio-psoas muscle (MRN). Using RT-PCR, the gene expression of inflammatory cytokines (IL-6; IL-8; IL-10; TNF-α; MCP-1) and adiponectin, myogenic proteins (myogenin, myo-D, MHC-2, MYH1/2, mTORC1, STAT3 and myostatin) as well as the expression of WNT pathway genes such as: WNT10b, WNT5a, GSK-3beta and sFRP5, Adipose tissue: Gene and protein expression analysis of IL-6 cytokines; IL-8; IL-10; TNF-alpha; IGF-1, adiponectin, markers inherent to the WNT pathway such as WNT5a, WNT10b, sFRP5 and GSK-3beta and the differentiation factor PPAR-gamma via RT-PCR and Western-Blot, respectively. RNA transcription will be performed as previously described, as will analysis of exosomes. Adipocytes will be isolated and the supernatant collected for pro- and anti-inflammatory cytokine testing using Luminex technolog, Bone tissue: RT-PCR will be used to evaluate the expression of the following genes: WNT5a, WNT10b, GSK-3beta, SOST, DKK-1 RUNX2, IGF-1 and osteocalcin. An immunohistochemical analysis will be performed on the bone to analyze the number and location of Teff and Treg cells. Skeletal tissues will be fixed and decalcified to stain slides with specific monoclonal antibodies, such as anti-CD4 and anti-FOXP3, to identify Teff and Treg cells., Synovial fluid: Measurement of pro- and anti-inflammatory/metabolic molecules using the Luminex assay as previously described., Serum: The following cytokines and adipokines will be evaluated by ELISA assays: IL-6; IL-8; IL-10 and adiponectin as well as bone turnover markers: CTX, P1NP, active and inactive osteocalcin, BSAP. The serum concentration of 25-hydroxy-vitamin D will be evaluated using radioimmunoassays. Biomarkers of the WNT pathway such as: serum sclerostin, DKK-1 and sFRP will be evaluated using ELISA assays., In order to monitor the safety of cholecalciferol supplementation, the patient's blood calcium level will also be measured at each time point of the study., PBMCs: Thanks to the execution of venous sampling, it will be possible to extract PMBCs to evaluate the frequency and phenotype of T cells. They will be evaluated by multiparametric flow cytometry to study CD4+, CD8+, Treg and TR3-56 T cells. A combination of the following fluorochrome-conjugated monoclonal antibodies will be used: anti-CD45, -CD3, -CD4, -CD8, -CD56, -CD25, -FoxP3, -CD45RA, -CCR7, -PD-1, -CTLA4. Dead cells detected by a viability dye will be excluded., PBMCs will be used to separate the two main subsets of T lymphocytes such as CD4+ and CD8+ T cells using a magnetic bead kit. The isolated cells will be cultured and stimulated or not via the TCR receptor; Cell supernatant will be analyzed via Luminex as previously described to measure both pro- and anti-inflammatory cytokines., Intramedullary fat: The quantification of intramedullary fat will take place via magnetic resonance spectroscopic (MRS)

Source: https://euclinicaltrials.eu/ctis-public/view/2025-520869-52-00